EU clinical trial 2023-507903-74-00: A Phase 3, Open Label, Multicenter, Baseline-controlled Sequential Dose Titration Study Followed by a Fixed Dose Observation Period to Evaluate Pharmacokinetics, Efficacy and Safety of Mirabegron Prolonged-release Microgranula-based Suspension in Children from 6 Months to Less Than 3 Years of Age with Neurogenic Detrusor Overactivity
Protocol code: 178-CL-207
Sponsor: Astellas Pharma Global Development Inc. (Pharmaceutical company). Phase: Therapeutic confirmatory (Phase III). Countries: Denmark (ended), Belgium (ended), Poland (ended), Germany (ended).
Therapeutic area(s): Phenomena and Processes [G] - Biological Phenomena [G16]
Gender: Female, Male. Age: 0-17 years. Enrolment: 6.
Status: Ended. Start date (EU): 2024-02-28. End date (EU): 2025-12-12. Decision date: 2023-12-07. Results received: No. Last updated: 2025-10-13.
Decision dates by country: BE: 2023-12-11, DK: 2023-12-07, PL: 2024-01-12, DE: 2024-04-02

Condition(s): Neurogenic detrusor overactivity (NDO)
Product: Mirabegron

Primary endpoint: Change from baseline in MCC after 24 weeks of study intervention (based on filling urodynamics)
Endpoint(s): Change from baseline in urodynamic measures: o Bladder compliance (ΔV/ΔP) at weeks 4 and 24 o Filling volume until first detrusor contraction (> 15 cm H2O) at weeks 4 and 24 o Number of uninhibited detrusor contractions until leakage or until maximum 135% of age-related bladder capacity, Change from baseline in e-diary measures: o Maximum and average catheterized daytime volume o Average morning catheterized volume (based on first catheterization after participant woke up) o Number of leakage episodes (per 24 h) o Number of dry (leakage-free) days per 7 days, Acceptability by P-OMAQ-C at weeks 4, 24, and 52, AEs, Vital signs, on site and SBPM; SBPM from baseline to EOS, Clinical laboratory tests (hematology, coagulation, biochemistry, eGFR, urinalysis), 12-lead ECG, Upper urinary tract ultrasound, AUC24, Ctrough, CL/F, VZ/F, Cmax and Tmax, Additional PK parameters may be calculated based on the model used

Source: https://euclinicaltrials.eu/ctis-public/view/2023-507903-74-00